EU clinical trial 2023-508094-88-00: ExclUsive endocRine therapy Or radiation theraPy for women aged ≥70 years with luminal A-like early stage breast cancer (EUROPA): a randomized phase 3 trial
Protocol code: EUROPA
Sponsor: University Of Florence (Educational Institution). Phase: Therapeutic confirmatory (Phase III). Countries: Italy (ongoing, recruiting).
Therapeutic area(s): Diseases [C] - Neoplasms [C04]
Gender: Female. Age: 65+ years. Enrolment: 926.
Status: Ongoing, recruiting. Start date (EU): 2021-02-08. Decision date: 2023-11-06. Results received: No. Last updated: 2025-05-05.

Condition(s): breast cancer
Product: EXEMESTANE, ANASTROZOLE, TAMOXIFEN, LETROZOLE

Primary endpoint: IBTR rate at 5 years., PROMs HRQoL measured by global quality of life score (QLQ-C30) using the GHS at 24 months
Endpoint(s): LRR rate at 5 years, CBC rate at 5 years, DM rate at 5 years, BCSS at 5 years, OS at 5 years, Safety, as assessed by the number and grade of participants with reported AEs at 5 years, Individual scales from QLQ-C30 and QLQ-BR45 scores at baseline, 3, 6, 12, 24 months, and 5 years, Rate of cosmesis assessment grade at baseline, 3, 6, 12, 24 months, and 5 years, PROMs HRQoL measured by ELD14 questionnaire (optional) at baseline, 12, 24 months, and 5 years

Source: https://euclinicaltrials.eu/ctis-public/view/2023-508094-88-00